EU clinical trial 2024-519372-22-00: A research study to look at the distribution and effects of coramitug on amyloid deposits in heart tissue using PET/CT imaging in people with ATTR amyloidosis
Protocol code: NN6019-7853
Sponsor: Novo Nordisk A/S (Pharmaceutical company). Phase: Human Pharmacology (Phase I)- Other. Countries: Netherlands (ongoing, recruiting).
Therapeutic area(s): Diseases [C] - Cardiovascular Diseases [C14]
Gender: Female, Male. Age: 18-64 years, 65+ years. Enrolment: 14.
Status: Ongoing, recruiting. Start date (EU): 2026-02-12. Decision date: 2025-07-01. Results received: No. Last updated: 2026-03-06.

Condition(s): transthyretin amyloid amyloidosis cardiomyopathy (ATTR-CM)

Source: https://euclinicaltrials.eu/ctis-public/view/2024-519372-22-00